EU clinical trial 2024-520440-42-00: Efficacy and safety of NNC0487-0111 s.c. once-weekly in participants with obesity (AMAZE 1)
Protocol code: NN9490-8021
Sponsor: Novo Nordisk A/S (Pharmaceutical company). Phase: Therapeutic confirmatory (Phase III). Countries: Denmark (ongoing, recruiting), France (ongoing, recruiting), Germany (ongoing, recruiting), Belgium (ongoing, recruiting).
Therapeutic area(s): Diseases [C] - Nutritional and Metabolic Diseases [C18]
Gender: Female, Male. Age: 18-64 years, 65+ years. Enrolment: 270.
Status: Ongoing, recruiting. Start date (EU): 2026-05-07. Decision date: 2026-05-04. Results received: No. Last updated: 2026-05-08.
Decision dates by country: BE: 2026-05-04, FR: 2026-05-06, DE: 2026-05-06, DK: 2026-05-05

Condition(s): Obesity
Product: NNC0487-0111 B 10146, NNC0487-0111 B 10145, Placebo, NNC0487-0111 B 10143, NNC0487-0111 B 10144, NNC0487-0111 B 10142, NNC0487-0111 B 10141

Primary endpoint: Relative change in body weight
Endpoint(s): CCI, CCI, CCI, Change in waist circumference, Change in systolic blood pressure (SBP), Change in Impact of Weight on Quality of Life-Lite Clinical Trials Version (IWQOL-Lite-CT) Physical Function score, CCI, Change in SF-36v2® Health Survey Acute (SF-36v2 Acute) physical functioning scorea, CCI, Change in body weight, Change in body mass index (BMI), CCI, Change in IWQOL-Lite-CT Physical composite score Psychosocial composite score Total score, CCI, CCI, CCI, Change in glycated haemoglobin (HbA1c), Change in fasting plasma glucose (FPG), Change in fasting insulin, Change in diastolic blood pressure (DBP), Change in lipids: Total cholesterol High-density lipoprotein (HDL) cholesterol Low-density lipoprotein (LDL) cholesterol Very low-density lipoprotein (VLDL) cholesterol Non-HDL cholesterol Triglycerides, Change in high-sensitivity C-reactive protein (hsCRP), CCI, CCI, Number of: Treatment Emergent Adverse Events (TEAEs) Treatment Emergent Serious Adverse Events (TESAEs) TEAEs leading to permanent treatment discontinuation, Extension phase secondary endpoints are as follows: Relative change in body weight, CCI, Change in body weight, Change in body mass index (BMI), CCI, Change in SF-36v2® Health Survey Acute (SF-36v2 Acute) physical functioning score, Change in Impact of Weight on Quality of Life-Lite Clinical Trials Version (IWQOL-Lite-CT): Physical composite score Physical functioning score Psychosocial composite score Total score, CCI, CCI, CCI, CCI, Change in waist circumference, Change in systolic blood pressure (SBP), Change in glycated haemoglobin (HbA1c), Change in fasting plasma glucose (FPG), Change in fasting insulin, Change in lipids: Total cholesterol High-density lipoprotein (HDL) cholesterol Low-density lipoprotein (LDL) cholesterol Very low-density lipoprotein (VLDL) cholesterol Non-HDL cholesterol Triglyceride, Change in high-sensitivity C-reactive protein (hsCRP), CCI, CCI, Number of: Treatment Emergent Adverse Events (TEAEs) Treatment Emergent Serious Adverse Events (TESAEs) TEAEs leading to permanent treatment discontinuation

Source: https://euclinicaltrials.eu/ctis-public/view/2024-520440-42-00